EU clinical trial 2023-507276-53-00: A Phase 2 Open-Label Study Evaluating Tolerability and Efficacy of Navitoclax Alone or in Combination with Ruxolitinib in Subjects with Myelofibrosis (REFINE)
Protocol code: M16-109
Sponsor: AbbVie Deutschland GmbH & Co. KG (Pharmaceutical company). Phase: Therapeutic exploratory (Phase II). Countries: Spain (ended), Italy (ended), Greece (ended), Croatia (ended).
Therapeutic area(s): Diseases [C] - Neoplasms [C04]
Gender: Female, Male. Age: 18-64 years, 65+ years. Enrolment: 58.
Status: Ended. Start date (EU): 2020-03-23. End date (EU): 2025-01-28. End date: 2025-01-30. Decision date: 2024-04-24. Results received: Yes. Last updated: 2024-05-13.
Decision dates by country: HR: 2024-04-26, GR: 2024-05-13, IT: 2024-04-26, ES: 2024-04-24

Condition(s): Myelofibrosis
Product: Navitoclax, Navitoclax, RUXOLITINIB

Primary endpoint: ≥ 35% spleen volume reduction from baseline (SVR35) at Week 24 measured by MRI/CT.
Endpoint(s): The secondary endpoints are at least 50% reduction in total symptom score from baseline measured by MFSAF 4.0; anemia response; and change in grade of bone marrow fibrosis.

Source: https://euclinicaltrials.eu/ctis-public/view/2023-507276-53-00